EU clinical trial 2023-505509-18-00: B-NHL 2013 - Treatment protocol of the NHL-BFM and the NOPHO study groups for mature aggressive B-cell lymphoma and leukemia in children and adolescents
Protocol code: B-NHL 2013
Sponsor: Universitaetsklinikum Muenster AöR (Hospital/Clinic/Other health care facility). Phase: Therapeutic confirmatory (Phase III). Countries: Norway (ongoing, recruitment ended), Germany (ongoing, recruitment ended), Finland (ongoing, recruitment ended), Sweden (ongoing, recruitment ended), Austria (ongoing, recruitment ended), Denmark (ongoing, recruitment ended), Czechia (ongoing, recruitment ended).
Therapeutic area(s): Diseases [C] - Neoplasms [C04]
Gender: Female, Male. Age: 0-17 years. Enrolment: 605.
Status: Ongoing, recruitment ended. Start date (EU): 2017-07-12. Decision date: 2023-09-21. Results received: No. Last updated: 2026-04-15.
Decision dates by country: CZ: 2023-09-22, SE: 2023-09-21, FI: 2023-09-22, DK: 2023-09-21, NO: 2023-09-25, AT: 2023-10-04, DE: 2023-09-21

Condition(s): mature aggressive B-cell lymphoma and leukemia in children and adolescents
Product: PREDNISOLONE, METHOTREXATE, METHOTREXATE, IFOSFAMIDE, ETOPOSIDE, CYTARABINE, RITUXIMAB, CYTARABINE, DEXAMETHASONE, DOXORUBICIN, VINCRISTINE, CYCLOPHOSPHAMIDE, VINDESINE

Primary endpoint: For R1/R2- patients with stage I+II the primary endpoint is event-free survival (EFS_T) defined as time from start of treatment up to event or to date of last contact for patients without event. The following occurrences are defined as an event: non-response, progressive disease or relapse, treatment related death, death of any other cause or diagnosis of secondary malignancies., For R2 patients with stage III disease (the 1st randomized study question) the primary endpoint is event-free survival (EFS_R) defined as time from randomization up to event or to date of last contact for patients without event. The following occurrences are defined as an event: non-response, progressive disease or relapse, treatment related death, death of any other cause or diagnosis of secondary malignancies., R3/R4 patients(pts)(2nd randomized question): 1.Event-free survival(EFS_T/EFS_R):time from start of treatment(SoT)/randomization up to event or to date of last contact(pts without event).Definition event: non-response,progressive disease or relapse,treatment related death,death of any other cause or diagnosis of secondary malignancies. 2.Immune reconstitution rate: percentage of pts achieving age adjusted normal B-cell counts(CD19+ subpopulations,normal age adjusted range) 12 months after SoT.

Source: https://euclinicaltrials.eu/ctis-public/view/2023-505509-18-00